EU clinical trial 2024-520054-38-00: First-in-paediatrics, open label, exploratory, externally controlled clinical trial to evaluate safety, efficacy and pharmacokinetics of 7-ethyl-10-hydroxy-camptothecin (SN-38) formulated as a biocompatible polymeric nanofiber membrane (CEB-01) for treatment, in addition to standard of care, of paediatric patients from birth to less than 18 years of age with a locally resectable tumours in comparison to standard of care.
Protocol code: CEB-01-RLP01-CT
Sponsor: Cebiotex S.L. (Pharmaceutical company). Phase: Therapeutic exploratory (Phase II). Countries: Spain (temporarily halted).
Therapeutic area(s): Diseases [C] - Neoplasms [C04]
Gender: Female, Male. Age: 0-17 years. Enrolment: 60.
Status: Temporarily halted. Start date (EU): 2025-05-06. Decision date: 2025-04-23. Results received: No. Last updated: 2026-02-02.

Condition(s): Desmoplastic small round cell tumour, Wilms tumour, Extracranial malignant rhabdoid tumour, High-risk neuroblastoma, Soft-tissue sarcoma, Synovial sarcoma, Germ cell tumour, Fibrolamellar hepatocellular carcinoma

Primary endpoint: Adverse Events (AE), serious and non-serious, with their frequency, severity, and relatedness to study drug and coded according to the most updated version of the Common Terminology Criteria for Adverse Events (CTCAE).
Endpoint(s): Progression-free survival (PFS)., Overall survival (OS)., Local recurrence-free survival (LRFS)., New lesions either distant or metastatic by RECIST 1.1., Paediatric Quality of Life Questionnaire (KIDSCREEN-27), Area under the concentration-time curve (AUC0-inf) of SN-38., Maximum concentration (Cmax) of SN-38., Time of maximum plasma concentration (Tmax) of SN-38., Terminal half-life (t1/2) of SN-38.

Source: https://euclinicaltrials.eu/ctis-public/view/2024-520054-38-00